EU clinical trial 2023-506589-30-00: Randomized, Double-blind, Placebo-controlled, Multicenter Phase 3 Study to Assess the Efficacy, Safety And Immunogenicity of Vaccination With ExPEC9V in the Prevention of Invasive Extraintestinal Pathogenic Escherichia coli Disease in Adults Aged 60 Years And Older with a History of Urinary Tract Infection in the Past 2 Years
Protocol code: VAC52416BAC3001
Sponsor: Janssen Vaccines & Prevention B.V. (Pharmaceutical company). Phase: Therapeutic confirmatory (Phase III). Countries: Netherlands (ended), Czechia (ended), Germany (ended), Spain (ended), France (ended), Sweden (ended), Denmark (ended).
Therapeutic area(s): Diseases [C] - Bacterial Infections and Mycoses [C01]
Gender: Female, Male. Age: 18-64 years, 65+ years. Enrolment: 5197.
Status: Ended. Start date (EU): 2022-02-09. End date (EU): 2025-08-14. End date: 2025-08-28. Decision date: 2024-06-12. Results received: Yes. Last updated: 2025-08-26.
Decision dates by country: DK: 2024-06-13, CZ: 2024-06-14, FR: 2024-06-13, DE: 2024-06-14, SE: 2024-06-13, ES: 2024-06-17, NL: 2024-06-12

Condition(s): Invasive Extraintestinal Pathogenic Escherichia coli Disease
Product: 0.9% Sodium Chloride, JNJ-78901563

Primary endpoint: First IED event, with microbiological confirmation from blood or other sterile sites, excluding IED cases with microbiological confirmation from urine only, caused by ExPEC9V O-serotypes O1, O2, O4, O6, O15, O16, O18, O25, and O75
Endpoint(s): 2. All IEDs (including multiple IEDs per participant) caused by ExPEC9V O serotypes, 3. First hospitalized IED event caused by ExPEC9V O serotypes, 4. First IED event meeting criteria for sepsis caused by ExPEC9V O serotypes, 5. First bacteremic IED event caused by ExPEC9V O serotypes, 6. First pyelonephritis event caused by ExPEC9V O serotypes, 7. First UTI event caused by ExPEC9V O serotypes, 8. All UTIs (including multiple UTIs per participant) caused by ExPEC9V O serotypes, 9. First IED event caused by E. coli, 10. First pyelonephritis event caused by E. coli, 11. First UTI event caused by E. coli, 12. Antibody titers to vaccine O-serotype antigens and EPA in the Immunogenicity Subset, as determined by multiplex ECL-based immunoassay and antibody titers to vaccine O-serotype antigens, as determined by multiplex opsonophagocytic killing assay (MOPA) on Day 1 (pre-vaccination), Day 30, Day 181, Year 1, Year 2, Year 3 and Year 4, 13. Solicited local and systemic AEs (collected until 14 days postvaccination [from Day 1 to Day 15] in the Safety Subset), 14. Unsolicited AEs (collected until 29 days post-vaccination [from Day 1 to Day 30] in all participants), 15. Serious adverse events (SAEs) in all participants, 16. SF-36 and EQ-5D-5L responses at scheduled timepoints, 17. Frailty index as a measure of frailty at baseline, Year 1, Year 2, Year 3, Year 4 and at the time of an IED, 18. Medical resource utilization for IED events caused by ExPEC9V O-serotypes, 19. Medical resource utilization for UTI events (Immunogenicity Subset only) and ABP events (Immunogenicity Subset only) caused by ExPEC9V O-serotypes, 20. Hospitalization and length of stay in the hospital, including intensive care unit (ICU) hospitalization and ICU length of stay, for IED, UTI or ABP events caused by ExPEC9V O-serotypes, 21. IED-related and all-cause mortality, 1. First IED event, with microbiological confirmation from blood, other sterile sites, or urine, caused by ExPEC9V O-serotypes

Source: https://euclinicaltrials.eu/ctis-public/view/2023-506589-30-00